EU clinical trial 2024-517010-15-01: Mesenchymal stromal cell therapy for rehabilitation after hip fracture.
Protocol code: KS-BM-MSC-HF-001
Sponsor: Region Uppsala (Hospital/Clinic/Other health care facility). Phase: Human Pharmacology (Phase I)- Other. Countries: Sweden (authorised, recruitment pending).
Therapeutic area(s): Not possible to specify; Diseases [C] - Musculoskeletal Diseases [C05]
Gender: Female, Male. Age: 65+ years. Enrolment: 10.
Status: Authorised, recruitment pending. Decision date: 2025-05-05. Results received: No. Last updated: 2026-07-08.
Decision dates by country: SE: 2025-07-07

Condition(s): Post-operative recovery after hip fracture surgery in frail elderly patients.

Source: https://euclinicaltrials.eu/ctis-public/view/2024-517010-15-01